EU clinical trial 2024-516377-69-01: A randomized placebo-controlled double-blinded trial of the treatment of MRSA throat carriage with either standard decolonization therapy or standard decolonization therapy combined with oral clindamycin
Sponsor: Region Hovedstaden (Hospital/Clinic/Other health care facility). Phase: Therapeutic use (Phase IV). Countries: Denmark (ended).
Therapeutic area(s): Diseases [C] - Bacterial Infections and Mycoses [C01]
Gender: Female, Male. Age: 18-64 years, 65+ years. Enrolment: 80.
Status: Ended. End date (EU): 2025-08-31. Decision date: 2024-10-23. Results received: Yes. Last updated: 2025-12-12.

Condition(s): MRSA throat carriage
Product: CLINDAMYCIN

Primary endpoint: MRSA negative swabs at 1 months
Endpoint(s): MRSA negative swabs after 6 months

Source: https://euclinicaltrials.eu/ctis-public/view/2024-516377-69-01